EU clinical trial 2023-505367-36-00: A PHASE 1 STUDY TO ASSESS THE EXCRETION BALANCE, PHARMACOKINETICS, AND METABOLISM OF 14CDC806 IN HEALTHY VOLUNTEERS
Protocol code: DCE806102
Sponsor: Dice Therapeutics Inc. (Pharmaceutical company). Phase: Human Pharmacology (Phase I)- Other. Countries: Netherlands (ended).
Therapeutic area(s): Diseases [C] - Skin and Connective Tissue Diseases [C17]
Gender: Male. Age: 18-64 years. Enrolment: 8.
Status: Ended. Start date (EU): 2023-08-24. End date (EU): 2023-10-02. Decision date: 2023-08-02. Results received: Yes. Last updated: 2023-08-02.

Condition(s): Healthy
Product: DC-806, [14C]-DC-806

Primary endpoint: Excretion and recovery of TRA and DC-806 (and any major metabolites, if applicable): in urine: CLr, Aeurine, and fe%urine, Excretion and recovery of TRA and DC-806 (and any major metabolites, if applicable): in feces (and vomitus, if available): Aefeces, Aetotal, fe%feces, and fe%total (and Aevomit and fevomit, if applicable) for TRA, PK parameters of TRA and DC-806 (and any major metabolites, if applicable) in whole blood and plasma, as appropriate: Cmax, tmax, kel, t1/2, AUC0-t, and AUC0-inf, PK parameters of TRA and DC-806 (and any major metabolites, if applicable) in whole blood and plasma, as appropriate: CL/F and Vz/F (DC-806 only), PK parameters of TRA and DC-806 (and any major metabolites, if applicable) in whole blood and plasma, as appropriate: Whole blood to plasma ratios for Cmax and AUC0-inf (TRA only)
Endpoint(s): Adverse events, Clinical laboratory, Vital signs, 12-lead electrocardiogram, Quantified and identified DC-806 major metabolites

Source: https://euclinicaltrials.eu/ctis-public/view/2023-505367-36-00